EU clinical trial 2026-525728-18-00: Rituximab for Treatment of Checkpoint Inhibitor Induced Immune Related Adverse Events
Sponsor: Region Hovedstaden (Hospital/Clinic/Other health care facility). Phase: Human Pharmacology (Phase I)- Other. Countries: Denmark (authorised, recruitment pending).
Therapeutic area(s): Diseases [C] - Immune System Diseases [C20]
Gender: Female, Male. Age: 18-64 years, 65+ years. Enrolment: 25.
Status: Authorised, recruitment pending. Decision date: 2026-03-30. Results received: No. Last updated: 2026-03-30.

Condition(s): All CTCAE (v. 6.0) grade 2-4 immune-related adverse events

Source: https://euclinicaltrials.eu/ctis-public/view/2026-525728-18-00